EU clinical trial 2023-507041-28-00: Long-term Follow-up Study for Participants of Kite-Sponsored Interventional Studies Treated With Gene-Modified Cells
Protocol code: KT-US-982-5968
Sponsor: Kite Pharma Inc. (Pharmaceutical company). Phase: Therapeutic exploratory (Phase II). Countries: Spain (ongoing, recruiting), Netherlands (ongoing, recruiting), France (ongoing, recruiting), Germany (ongoing, recruiting), Austria (ongoing, recruiting), Belgium (ongoing, recruiting), Italy (ongoing, recruiting).
Therapeutic area(s): Diseases [C] - Neoplasms [C04]
Gender: Female, Male. Age: 0-17 years, 18-64 years, 65+ years. Enrolment: 96.
Status: Ongoing, recruiting. Start date (EU): 2022-11-28. Decision date: 2023-11-17. Results received: No. Last updated: 2026-06-08.
Decision dates by country: NL: 2023-11-22, BE: 2024-09-10, ES: 2023-11-17, FR: 2023-11-23, AT: 2024-07-01, DE: 2023-12-01, IT: 2024-07-23

Condition(s): Solid and Hematological Malignancies
Product: KITE-363, YESCARTA 0.4 – 2 x 10e8 cells dispersion for infusion, Tecartus 0.4 - 2 x 10e8 cells dispersion for infusion

Primary endpoint: Assess the occurrence of the following late-onset targeted AEs/SAEs suspected to be possibly related to gene-modified cells:, Neurologic disorders: type, date of onset, severity, treatment, and date of resolution, Autoimmune disorders: type, date of onset, severity, treatment, and date of resolution, Hematologic disorders: type, date of onset, severity, treatment, and date of resolution, Serious infections (eg, viral, bacterial, or fungal): type, organism, and timing of infection, New malignancies: time to development of the New malignancy, type, location, staging and molecular mechanism (including testing for presence of the chimeric antigen receptor transgene and RCR/RCL, Height, weight, and sexual maturation of pediatric and adolescent subjects
Endpoint(s): Subsequent anti-cancer therapies, Survival status, Cause of death, Overall rates of RCR/RCL, Status of the primary malignant disease

Source: https://euclinicaltrials.eu/ctis-public/view/2023-507041-28-00